EU clinical trial 2023-503580-42-00: A Phase 1b Study to Evaluate the Safety, Tolerability, and Pharmacokinetics/Pharmacodynamics of MK‑0482 in Participants with Relapsed or Refractory Acute Myeloid Leukemia or Chronic Myelomonocytic Leukemia
Protocol code: MK-0482-002
Sponsor: Merck Sharp & Dohme LLC (Pharmaceutical company). Phase: Human Pharmacology (Phase I)- Other. Countries: Spain (ended).
Therapeutic area(s): Diseases [C] - Neoplasms [C04]
Gender: Female, Male. Age: 18-64 years, 65+ years. Enrolment: 15.
Status: Ended. Start date (EU): 2023-05-16. End date (EU): 2023-12-11. End date: 2023-12-12. Decision date: 2023-07-05. Results received: Yes. Last updated: 2023-11-20.

Condition(s): Active CNS leukemia.

Primary endpoint: Number of participants who experience a dose-limiting toxicity (DLT), Number of participants who experience at least one adverse event (AE), Number of participants who discontinue study treatment due to an AE
Endpoint(s): Maximum plasma concentration (Cmax), Trough plasma concentration (Ctrough), Complete remission (CR) rate, Composite CR rate, Objective response rate (ORR)

Source: https://euclinicaltrials.eu/ctis-public/view/2023-503580-42-00